EU clinical trial 2023-510004-49-00: DOVIPA, a phase II study evaluating efficacy and safety of DOstarlimab and oral VItamin D3 with folinic acid, 5FU, Irinotecan plus oxalipaltin (mFOLFIRINOX) in non pretreated metastatic PAncreatic Cancer.
Protocol code: 2023_0111
Sponsor: Hospital Foch (Hospital/Clinic/Other health care facility). Phase: Therapeutic exploratory (Phase II). Countries: France (ongoing, recruitment ended).
Therapeutic area(s): Diseases [C] - Neoplasms [C04]
Gender: Female, Male. Age: 18-64 years, 65+ years. Enrolment: 35.
Status: Ongoing, recruitment ended. Start date (EU): 2025-02-18. Decision date: 2024-08-01. Results received: No. Last updated: 2026-04-09.

Condition(s): non pretreated metastatic PAncreatic Cancer
Product: ZYMAD 10 000 UI/ml, solution buvable en gouttes, Oxaliplatin medac 5 mg/ml concentrate for solution for infusion, Folinic acid (as calcium folinate) 10 mg/ml solution for injection/infusion, JEMPERLI 500 mg concentrate for solution for infusion, IRINOTECAN MEDAC 20 mg/ml, solution à diluer pour perfusion, 5-Fluorouracil Sandoz 50 mg/ml koncentrátum oldatos infúzióhoz

Primary endpoint: The primary endpoint of this study is the Objective Response Rate (ORR).
Endpoint(s): 1. To assess the safety and tolerability of mFOLFIRINOX + dostarlimab + HD vitamin D3 according to Common Terminology Criteria for Adverse Events (CTCAE) version 5.0, 2. To evaluate the antitumor efficacy of mFOLFIRINOX + dostarlimab + HD Vitamin D3.

Source: https://euclinicaltrials.eu/ctis-public/view/2023-510004-49-00